EU clinical trial 2023-503634-50-01: A Phase III, Randomized, Investigator-Blinded, Active-Controlled Study of Efficacy and Safety of Efepoetin Alfa for Treatment of Anemia in Patients with Chronic Kidney Disease on Dialysis
Protocol code: GX-E4-CKD-002
Sponsor: Genexine Inc. (Pharmaceutical company). Phase: Therapeutic confirmatory (Phase III). Countries: Italy (ongoing, recruiting), Czechia (ongoing, recruiting), Poland (ongoing, recruiting), Bulgaria (ongoing, recruiting), Romania (ongoing, recruiting), Slovakia (ongoing, recruiting).
Therapeutic area(s): Diseases [C] - Hemic and Lymphatic Diseases [C15]
Gender: Female, Male. Age: 18-64 years, 65+ years. Enrolment: 272.
Status: Ongoing, recruiting. Start date (EU): 2025-07-22. Decision date: 2024-10-02. Results received: No. Last updated: 2026-04-20.
Decision dates by country: BG: 2024-10-07, IT: 2024-10-03, CZ: 2024-10-02, PL: 2024-10-07, SK: 2026-01-19, RO: 2026-01-19

Condition(s): Anemia in patients with chronic kidney disease on dialysis
Product: GX-E4, Aranesp 100 micrograms solution for injection in pre-filled syringe, Aranesp 30 micrograms solution for injection in pre-filled syringe, GX-E4, Aranesp 60 micrograms solution for injection in pre-filled syringe, GX-E4, Aranesp 20 micrograms solution for injection in pre-filled syringe

Primary endpoint: The mean change from Baseline in Hb averaged over Week 20 to Week 28 without the use of rescue therapy* (defined in Section 7.9) within 6 weeks prior to and during the 8-week evaluation period. Baseline value is defined as the mean of the last screening value and Day1 (Visit 2) value.
Endpoint(s): Mean change from Baseline in Hb averaged over Week 20 to Week 28, regardless of whether the patient received rescue therapy., Mean change from Baseline in Hb level averaged over the maintenance period, regardless of whether the patient received rescue therapy, Proportion of patients who maintain Hb level at 10.0-12.0 g/dL over Week 20 to Week 28*, and over the maintenance period, regardless of whether the patient received rescue therapy., Proportion of patients with mean Hb ≥ 10.0 g/dL averaged over Week 20 to Week 28*, and over the maintenance period, regardless of whether the patient received rescue therapy., Proportion of patients with Hb > 12.0 g/dL over Week 20 to Week 28, and over the maintenance period, regardless of whether the patient received rescue therapy., Proportion of patients requiring rescue therapy during study treatment and time to rescue therapy from date of first dose of study treatment., Proportion of patients receiving rescue therapy over Week 20 to Week 28, and over the maintenance period., Mean dose of the IP over Week 20 to Week 28, and over the maintenance period., Mean change in QoL from Day 1 (V2) over time assessed through the 36-Item Health Survey 1.0 Questionnaire (Rand SF-36).

Source: https://euclinicaltrials.eu/ctis-public/view/2023-503634-50-01